EU clinical trial 2024-519883-42-00: A Randomized, Double-Blind, Multicenter, Pharmacokinetic Equivalence Clinical Trial of QL2107 (Keytruda® Biosimilar Candidate) in Comparison with Keytruda® (Pembrolizumab) for Adjuvant Therapy to Demonstrate Pharmacokinetic Similarity in Subjects with Resected Non-Small Cell Lung Cancer.
Protocol code: QL2107-102
Sponsor: Qilu Pharmaceutical Co. Ltd. (Pharmaceutical company). Phase: Therapeutic confirmatory (Phase III). Countries: Poland (ongoing, recruiting), Spain (ongoing, recruiting), Romania (ongoing, recruitment ended), Hungary (ongoing, recruiting), Greece (ongoing, recruiting).
Therapeutic area(s): Diseases [C] - Neoplasms [C04]
Gender: Female, Male. Age: 18-64 years, 65+ years. Enrolment: 52.
Start date (EU): 2025-10-08. Decision date: 2025-08-26. Results received: No. Last updated: 2026-04-28.
Decision dates by country: PL: 2025-08-29, ES: 2025-08-28, HU: 2025-09-01, GR: 2025-08-26, RO: 2025-09-01

Condition(s): Non-small cell lung cancer
Product: QL2107, PEMBROLIZUMAB

Primary endpoint: Area under the concentration time curve for 1 dosing interval (tau = 21 days) after a single (initial) dose (AUC tau,sd) of QL2107 and Keytruda® (Cycle 1), Area under the concentration time curve for 1 dosing interval (tau = 21 days) at steady state (AUC tau,ss) of QL2107 and Keytruda® (Cycle 7)
Endpoint(s): Maximum (peak) serum concentration after a single dose (C max,sd) of QL2107 and Keytruda® (initial dose at Cycle 1)., Maximum (peak) serum concentration at steady state (C max,ss) of QL2107 and Keytruda® (Cycle 7)., The trough serum concentration measured before the next dose is administered (C trough) of QL2107 and Keytruda® (predose samples) at Cycle 2 (Week 4), Cycle 4 (Week 10), Cycle 5 (Week 13), Cycle 6 (Week 16), Cycle 7 (Week 19), Cycle 10 (Week 28) and Cycle 14 (Week 40).

Source: https://euclinicaltrials.eu/ctis-public/view/2024-519883-42-00